EU clinical trial 2024-516824-32-00: I4V-MC-KHAB: A Multicenter, Open-Label, Pharmacokinetic and Safety Study of Baricitinib in Pediatric Patients From 1 Year to Less Than 18 Years Old Hospitalized With COVID-19
Protocol code: I4V-MC-KHAB
Sponsor: Eli Lilly & Co. (Pharmaceutical company). Phase: Therapeutic confirmatory (Phase III). Countries: Belgium (ended), Spain (ended).
Therapeutic area(s): Diseases [C] - Respiratory Tract Diseases [C08]
Gender: Female, Male. Age: 0-17 years. Enrolment: 4.
Status: Ended. Start date (EU): 2021-11-15. End date (EU): 2024-11-03. End date: 2024-11-04. Decision date: 2024-09-27. Results received: Yes. Last updated: 2025-08-15.
Decision dates by country: BE: 2024-09-27, ES: 2024-10-03

Condition(s): Covid19 Corona Virus Infection
Product: Baricitinib

Primary endpoint: Pharmacokinetics (PK): Area Under Concentration Curve (AUC) of Baricitinib, PK: Maximum Concentration (Cmax) of Baricitinib

Source: https://euclinicaltrials.eu/ctis-public/view/2024-516824-32-00